EU clinical trial 2024-512477-27-00: REFRaME-O1: A Phase 2/3 Open-label Study Evaluating the Efficacy and Safety of Luveltamab Tazevibulin (STRO-002) versus Investigator’s Choice (IC) Chemotherapy in Women with Relapsed Platinum-resistant Epithelial Ovarian Cancer (Including Fallopian Tube or Primary Peritoneal Cancers) Expressing Folate Receptor Alpha (FOLR1)
Protocol code: STRO-002-GM3
Sponsor: Sutro Biopharma Inc. (Pharmaceutical company). Phase: Therapeutic exploratory (Phase II). Countries: Austria (ended), Finland (not authorised), Czechia (ended), Italy (ended), Germany (ended), Ireland (ended), Spain (ended), Hungary (ended), Belgium (ended).
Therapeutic area(s): Diseases [C] - Female Urogenital Diseases and Pregnancy Complications [C13]
Gender: Female. Age: 18-64 years, 65+ years. Enrolment: 193.
Status: Ended. End date (EU): 2025-03-28. End date: 2025-08-15. Decision date: 2024-07-01. Results received: No. Last updated: 2025-04-18.
Decision dates by country: FI: 2024-07-02, AT: 2024-07-08, ES: 2024-07-01, HU: 2024-07-03, CZ: 2024-07-03, BE: 2024-07-04, DE: 2024-07-08, IE: 2024-07-05, IT: 2024-07-03

Condition(s): Advanced Epithelial Ovarian Cancer (including Fallopian Tube or Primary Peritoneal cancers)
Product: HYCAMTIN 4 mg powder for concentrate for solution for infusion, TAXOL 6 mg/ml, concentrato per soluzione per infusione., Neulasta 6 mg solution for injection, Caelyx pegylated liposomal 2 mg/ml concentrate for solution for infusion, GEMZAR 1000 mg, poudre pour solution pour perfusion

Primary endpoint: • PFS per RECIST 1.1, • Objective response rate (ORR) per RECIST 1.1
Endpoint(s): • Overall survival (OS), • Duration of response (DOR) per RECIST 1.1, • Incidence and severity of AEs and clinical laboratory abnormalities per NCI CTCAE V5.0, • Change from baseline to Week 8 (for q4w) or Week 9 (for q3w) in the score for the abdominal GI symptoms subscale

Source: https://euclinicaltrials.eu/ctis-public/view/2024-512477-27-00